EU clinical trial 2023-508105-24-00: An International Multicenter, Randomized, Double-Blind, Placebo-Controlled Trial of the Safety and Efficacy of Anti-Coronavirus Hyperimmune Intravenous Immunoglobulin for the Treatment of Adult Outpatients in Early Stages of COVID-19
Protocol code: INSIGHT012
Sponsor: University Of Minnesota (Educational Institution). Phase: Therapeutic confirmatory (Phase III). Countries: Greece (ended), Spain (ended), Denmark (ended).
Therapeutic area(s): Diseases [C] - Virus Diseases [C02]
Gender: Female, Male. Age: 18-64 years, 65+ years. Enrolment: 160.
Status: Ended. Start date (EU): 2021-11-11. End date (EU): 2026-05-18. Decision date: 2024-03-25. Results received: No. Last updated: 2026-04-28.
Decision dates by country: DK: 2024-03-25, GR: 2024-05-09, ES: 2024-03-26

Condition(s): COVID-19
Product: Anti-COVID-19 Hyperimmune Globulin (Human), Normal saline, volume matched to test product; provided by site

Primary endpoint: Asymptomatic and no limitations in usual activity due to COVID-19, Mild COVID-19 illness or minor limitations to usual activity, Moderate COVID-19 illness and major limitations to usual activity, Severe COVID-19 or other serious disease manifestation, Critical illness from COVID-19 or Death
Endpoint(s): All-cause hospitalization or death through 28 days., All-cause mortality through 28 days., Significant disease progression through 28 days, using a time to event analysis with outcome defined by fulfilling criteria for category 4 or 5 on the ordinal scale., Distribution of ordinal scale outcome at Day 4, 14, and 28., The proportion of participants with any disease progression at Day 7, using a sliding dichotomous scale progression defined by a categorization on the ordinal scale that is worse than the status at entry., The proportion of participants who progress to categories 3-5 on the clinical ordinal scale at Day 7 among participants in categories 1 or 2 of the ordinal scale at entry., The severity of progression during follow-up, defined by the worst health status achieved on the clinical ordinal scale at any point by Day 7, 14, and 28., The proportion of participants that attain their pre-COVID health status without limitations in usual activity (i.e., category 1) at Day 7, 14, and 28., Change in quantitative measures of viral burden between Day 0 and Day 7, including serum antigen levels (e.g., nucleocapsid antigen) as well as by polymerase chain reaction (PCR) from nasal and saliva specimens., Change in SARS-CoV-2 antibody levels between Day 0 and Day 7, including subclasses and neutralizing titers., Utilization of health care resources through 28 days, defined by the proportion of participants that had health care engagement for the purposes of medical evaluation and/or management of COVID-19 illness (e.g., via telehealth, clinic, urgent care, emergency room, or hospitalization)., The severity of respiratory symptoms and dysfunction, as the worst status through 28 days, including: a) no respiratory symptoms, b) upper respiratory symptoms, c) lower respiratory symptoms without hypoxia, c) hypoxia requiring conventional oxygen supplementation by nasal canula, d) respiratory failure requiring high-flow oxygen delivery device or non-invasive ventilation, or e) respiratory failure requiring mechanical ventilation or extra-corporeal membrane oxygenation (ECMO)., Hypoxemia through Day 7, as evaluated through participant assessments of saturation of oxygen (SpO2) levels. Comparisons between groups will consider differences in SpO2 levels as well as explore the frequency of levels that drop below clinical thresholds (e.g., <94% and <90% on room air for those without COPD or use of supplemental O2 prior to COVID-19)., Proportion of patients starting other treatments targeting COVID-19., Associations between changes in laboratory assessments from Day 0 to Day 7, and ordinal scale distribution and clinical outcomes over follow-up.

Source: https://euclinicaltrials.eu/ctis-public/view/2023-508105-24-00